EU clinical trial 2023-510291-32-00: A Randomised, Double-blind, Parallel Group, Placebo Controlled, 4-Week, Phase II Study to Evaluate the Effect of AZD4604 on Airway Inflammation and Biomarkers in Adults with Asthma - Artemisia study
Protocol code: D8210C00005
Sponsor: AstraZeneca AB (Pharmaceutical company). Phase: Therapeutic exploratory (Phase II). Countries: Germany (ended), Denmark (ended), Spain (ended).
Therapeutic area(s): Diseases [C] - Respiratory Tract Diseases [C08]
Gender: Female, Male. Age: 18-64 years. Enrolment: 20.
Status: Ended. Start date (EU): 2024-09-26. End date (EU): 2025-08-13. End date: 2025-10-15. Decision date: 2024-09-02. Results received: No. Last updated: 2025-07-02.
Decision dates by country: DK: 2024-09-02, ES: 2024-09-05, DE: 2024-09-04

Condition(s): Asthma
Product: AZD4604, Azd4604 placebo, AZD4604

Primary endpoint: Change from baseline to end of IMP administration in expression of T2, non-T2, and JAK1-related genes and gene signatures in bronchial brushings.
Endpoint(s): Change from baseline to end of IMP administration in STAT phosphorylation in bronchial biopsies, Change in number of airway cells, including but not limited to inflammatory cells, airway smooth muscle cells, and goblet cells from baseline to end of IMP administration in bronchial biopsies (cells per mm² determined by microscopic evaluation)

Source: https://euclinicaltrials.eu/ctis-public/view/2023-510291-32-00